EU clinical trial 2023-506162-31-00: A randomized controlled trial comparing sequential of two shots of CFA vs CFA + rFSH for Elective Fertility Preservation. The 2-shot protocol.
Protocol code: FSD-SEQ-2023-09
Sponsor: Santiago Dexeus Font Fundacio Privada (Laboratory/Research/Testing facility). Phase: Therapeutic confirmatory (Phase III). Countries: Spain (ended).
Therapeutic area(s): Diseases [C] - Female Urogenital Diseases and Pregnancy Complications [C13]
Gender: Female. Age: 18-64 years. Enrolment: 194.
Status: Ended. Start date (EU): 2023-12-12. End date (EU): 2026-07-13. Decision date: 2023-10-26. Results received: No. Last updated: 2024-04-17.

Condition(s): Infertility
Product: Elonva 100 micrograms solution for injection, Cerazet 75 microgramos comprimidos recubiertos con película, Elonva 150 micrograms solution for injection, Decapeptyl diario 0,1 mg polvo y disolvente para solución inyectable, Puregon 900 IU/1.08 ml solution for injection

Primary endpoint: To compare the number of MII oocytes retrieved after final oocyte maturation with a 2-shot sequential administration of CFA or a unique administration of CFA followed by daily rFSH for controlled ovarian stimulation in patients undergoing elective fertility preservation.
Endpoint(s): Total number of oocytes retrieved, Endocrine profile on the day of trigger (FSH, LH, estradiol, progesterone), Incidence of OHSS, Quality of life questionnaire “FertiQoL”, Length of stimulation

Source: https://euclinicaltrials.eu/ctis-public/view/2023-506162-31-00